EU clinical trial 2023-506541-39-00: A Phase 1 Study Evaluating the Safety, Tolerability, and Pharmacokinetics of Tarlatamab in Subjects With Small Cell Lung Cancer (DeLLphi-300)
Protocol code: 20160323
Sponsor: Amgen Inc. (Pharmaceutical company). Phase: Human Pharmacology (Phase I)- First administration to humans. Countries: Spain (ongoing, recruitment ended), Germany (ongoing, recruitment ended), Poland (ongoing, recruitment ended), Netherlands (ended), Austria (ended), France (ongoing, recruitment ended).
Therapeutic area(s): Diseases [C] - Neoplasms [C04]
Gender: Female, Male. Age: 18-64 years, 65+ years. Enrolment: 118.
Start date (EU): 2018-08-03. Decision date: 2024-07-18. Results received: No. Last updated: 2026-06-18.
Decision dates by country: NL: 2024-07-22, AT: 2024-07-22, DE: 2024-07-19, PL: 2024-08-04, ES: 2024-07-18, FR: 2024-07-19

Condition(s): Small Cell Lung Cancer

Source: https://euclinicaltrials.eu/ctis-public/view/2023-506541-39-00